EU clinical trial 2024-510878-24-00: A trial in healthy volunteers to study safety, tolerability, CS014-levels and effects in the body, after single and repeated doses of CS014, for the first time in humans.
Protocol code: CS014-001
Sponsor: Cereno Scientific AB (Pharmaceutical company). Phase: Human Pharmacology (Phase I)- First administration to humans. Countries: Sweden (ended).
Therapeutic area(s): Diseases [C] - Cardiovascular Diseases [C14]
Gender: Female, Male. Age: 18-64 years, 65+ years. Enrolment: 48.
Status: Ended. Start date (EU): 2024-06-24. End date (EU): 2025-04-15. Decision date: 2024-06-18. Results received: No. Last updated: 2024-06-18.

Condition(s): Cardiovascular disease

Source: https://euclinicaltrials.eu/ctis-public/view/2024-510878-24-00